EU clinical trial 2023-510456-23-00: Study to assess the safety and tolerability of CMR316 in healthy volunteers and patients with Idiopathic Pulmonary Fibrosis.
Protocol code: CBR-CMR316-3001
Sponsor: The Scripps Research Institute (Educational Institution). Phase: Human Pharmacology (Phase I)- First administration to humans. Countries: Germany (ended).
Therapeutic area(s): Diseases [C] - Respiratory Tract Diseases [C08]
Gender: Female, Male. Age: 18-64 years, 65+ years. Enrolment: 112.
Status: Ended. Start date (EU): 2024-08-14. End date (EU): 2026-06-23. End date: 2026-06-24. Decision date: 2024-04-09. Results received: No. Last updated: 2026-05-08.
Decision dates by country: DE: 2024-06-11

Condition(s): Idiopathic Pulmonary Fibrosis

Source: https://euclinicaltrials.eu/ctis-public/view/2023-510456-23-00